EU clinical trial 2023-509775-16-00: Assessment of the safety and effectiveness of vedolizumab induction therapy compared to standard infliximab therapy in pediatric patients with ulcerative colitis "VEDI-UC”
Protocol code: VEDI-UC
Sponsor: Instytut Pomnik Centrum Zdrowia Dziecka (Hospital/Clinic/Other health care facility). Phase: Therapeutic exploratory (Phase II). Countries: Poland (ongoing, recruiting).
Therapeutic area(s): Diseases [C] - Digestive System Diseases [C06]
Gender: Female, Male. Age: 0-17 years. Enrolment: 66.
Status: Ongoing, recruiting. Start date (EU): 2024-10-03. Decision date: 2024-05-06. Results received: No. Last updated: 2024-12-20.

Condition(s): Ulcerative colitis
Product: Entyvio 300 mg powder for concentrate for solution for infusion, INFLIXIMAB

Primary endpoint: Safety of biological treatment with vedolizumab and infliximab defined by the number of drug-related adverse events (AEs).
Endpoint(s): 1. Clinical response - decrease in PUCAI value by min. 20 points 2. Clinical remission - PUCAI value < 10 points 3. Mucosal remission - Mayo endoscopic score = 0 4. Clinical response in the total Mayo scale - reduction of at least 3 points 5. Clinical remission in the Mayo total scale - value ≤ 2 points 6. Clinical response in the partial Mayo scale - reduction of at least 2 points 7. Clinical remission in the Mayo partial scale - value ≤ 2 points

Source: https://euclinicaltrials.eu/ctis-public/view/2023-509775-16-00